EU clinical trial 2024-512652-38-00: A Randomized, Controlled, Open-Label, Phase 2 Study of Cemiplimab as a Single Agent and in Combination With RP1 in Patients With Advanced Cutaneous Squamous Cell Carcinoma [CERPASS]
Protocol code: RPL-002-18
Sponsor: Replimune Group Inc. (Pharmaceutical company). Phase: Therapeutic exploratory (Phase II). Countries: Spain (ended), Greece (ended), Germany (ended), Poland (ended), Bulgaria (ended), France (ended).
Therapeutic area(s): Diseases [C] - Neoplasms [C04]
Gender: Female, Male. Age: 18-64 years, 65+ years. Enrolment: 143.
Status: Ended. Start date (EU): 2021-01-25. End date (EU): 2026-01-14. End date: 2026-01-15. Decision date: 2024-11-19. Results received: No. Last updated: 2026-02-02.
Decision dates by country: ES: 2024-11-19, FR: 2024-11-20, DE: 2024-11-22, GR: 2025-01-22, BG: 2024-12-17, PL: 2024-12-13

Condition(s): Cutaneous Squamous Cell Carcinoma
Product: Vusolimogene oderparepvec, Vusolimogene oderparepvec, LIBTAYO 350 mg concentrate for solution for infusion., LIBTAYO 350 mg concentrate for solution for infusion., LIBTAYO 350 mg concentrate for solution for infusion., Vusolimogene oderparepvec, Vusolimogene oderparepvec, Vusolimogene oderparepvec

Primary endpoint: The primary efficacy endpoints for this study are ORR and CRR according to blinded independent review:, ORR/CRR will be determined using modified Response Evaluation Criteria in Solid Tumors (RECIST) version 1.1 (RECIST 1.1) as specified in Appendix 1 for radiologically assessable lesions and clinical and composite response criteria as specified in Appendix 2 for clinically assessable lesions. Confirmatory scans should also be obtained ≥4 weeks following initial documentation of objective response or progressive disease (PD)., In patients suspected of achieving a complete response (CR) by clinical assessment, tumor biopsies may be used in the final determination of CR.
Endpoint(s): The key secondary outcome measure is PFS by blinded independent review., ORR/CRR by investigator review, ORR/CRR for patients with metastatic (nodal or distant) disease by investigator and BIRC review, ORR/CRR for patients with locally advanced disease by investigator and blinded independent review, ORR/CRR for patients having previously received systemic CSCC-directed therapy by investigator and blinded independent review, ORR/CRR for patients not having previously received systemic CSCC-directed therapy by investigator and blinded independent review, DOR by investigator and blinded independent review, PFS by investigator review, OS, 3-year survival, Change in scores of patient-reported outcomes on EORTC QLQ-C30, To assess the safety and tolerability of cemiplimab alone and combined with RP1

Source: https://euclinicaltrials.eu/ctis-public/view/2024-512652-38-00